EU clinical trial 2024-512878-98-00: An Open-label Multicenter Phase 1b-2 Study of Elacestrant in Combination with Abemaciclib in Women and Men with Brain Metastasis from Estrogen Receptor Positive, HER-2 Negative Breast Cancer (ELECTRA)
Protocol code: ELA-0121
Sponsor: Stemline Therapeutics Inc. (Pharmaceutical company). Phase: Phase I and Phase II (Integrated)- Other. Countries: Belgium (ongoing, recruiting), Italy (ongoing, recruiting), France (ongoing, recruiting), Spain (ongoing, recruiting), Greece (ongoing, recruiting), Germany (ongoing, recruiting).
Therapeutic area(s): Diseases [C] - Neoplasms [C04]
Gender: Female, Male. Age: 18-64 years, 65+ years. Enrolment: 131.
Status: Ongoing, recruiting. Start date (EU): 2023-05-16. Decision date: 2024-10-01. Results received: No. Last updated: 2026-08-06.
Decision dates by country: BE: 2024-10-01, DE: 2024-10-04, GR: 2024-12-17, ES: 2024-10-15, IT: 2024-10-21, FR: 2024-10-24

Condition(s): Brain Metastasis from Estrogen Receptor Positive, HER-2 Negative Breast Cancer
Product: ORSERDU 345 mg film-coated tablets, ABEMACICLIB, ABEMACICLIB, ABEMACICLIB, ORSERDU 86 mg film-coated tablets

Primary endpoint: Phase 1b: The primary study endpoint is determination of the RP2D based on the observed number of DLTs during the first cycle., Phase 2:− ORR per overall RECIST version 1.1;; defined as the proportion of participants achieving a best overall response of confirmed partial response (PR) or confirmed complete response (CR), per BICR.
Endpoint(s): Phase 1b: − AEs and serious adverse events (SAEs) and changes in clinical laboratory values, vital signs measurements and ECG parameters., Phase 1b: − Plasma PK parameters including, but not limited to, the area under the plasma concentration-time curve over the dosing interval (AUC0-tau), Cmax, time of the maximum observed plasma concentration (Tmax), and Ctrough., Phase 1b: − ORR, DoR, CBR at 16 weeks, CBR at 24 weeks, and PFS as per local investigator's assessment and per blinded independent central review (BICR).., Phase 1b: − OS., Phase 2: − DoR per overall RECIST version 1.1 per BICR., Phase 2: − Plasma PK parameters including, but not limited to AUC0-tau, Cmax, Tmax, and Ctrough., Phase 2: − Change in participants’ responses to EORTC QLQ-C30, EQ5D-5L, and EORTC QLQ-BN20., Phase 2: − Change in participants’ scores in MMSE-2 SV, and NANO scale., Phase 2: − AEs and SAEs and changes in clinical laboratory values, vital signs measurements and ECG parameters, Phase 2: - iORR per RANO-BM (iORR-RANO) per BICR, Phase 2: - iORR per intracranial RECIST version 1.1 (iORR-RECIST) per BICR, Phase 2: Intracranial DoR per RANO--BM (iDoR-RANO) per BICR, Phase 2: Intracranial DoR per intracranial RECIST version 1.1 (iDoR-RECIST) per BICR, Phase 2: CBR per overall RECIST version 1.1at 16 weeks (CBR-16w) per BICR, Phase 2: Intracranial CBR per RANO-BM at 16 weeks (iCBR-RANO-16w) per BICR, Phase 2: Intracranial CBR per intracranial RECIST version 1.1at 16 weeks (iCBR-RECIST-16w) per BICR, Phase 2: CBR per overall RECIST version 1.1 at 24 weeks (CBR-24w) per BICR, Phase 2:Intracranial CBR per RANO-BM at 24 weeks (iCBR-RANO-24w) per BICR, Phase 2: Intracranial CBR per intracranial RECIST version 1.1 at 24 weeks (iCBR-RECIST-24w) per BICR, Phase 2:PFS per overall RECIST version 1.1 per BICR, Phase 2: Intracranial PFS (iPFS) per BICR, Phase 2: All the above endpoints will be also assessed per local reading, Phase 2: OS is defined as the length of time from first intake until the date of death from any cause

Source: https://euclinicaltrials.eu/ctis-public/view/2024-512878-98-00